EU clinical trial 2024-517205-82-00: A multicentre, open-label phase 2 study to evaluate the efficacy and safety of pembrolizumab in the treatment of advanced, progressive adrenocortical carcinoma
Protocol code: PEMBR-01
Sponsor: Narodowy Instytut Onkologii Im. Marii Sklodowskiej-Curie Panstwowy Instytut Badawczy (Hospital/Clinic/Other health care facility). Phase: Therapeutic exploratory (Phase II). Countries: Poland (ongoing, recruitment ended).
Therapeutic area(s): Diseases [C] - Neoplasms [C04]
Gender: Female, Male. Age: 18-64 years, 65+ years. Enrolment: 24.
Status: Ongoing, recruitment ended. Start date (EU): 2023-01-20. Decision date: 2024-09-22. Results received: No. Last updated: 2026-04-07.

Condition(s): adrenocortical carcinoma
Product: PEMBROLIZUMAB

Primary endpoint: Objective Response Rate (ORR), Progression-Free Survival (PFS), Duration of Response (DoR), Overall Survival (OS)
Endpoint(s): Quality of life assesed by QLQ-C30 questionnaire, Number of Adverse Events and Serious Adverse Events (AEs and SAEs) related and unrelated to treatment according to CTCAE

Source: https://euclinicaltrials.eu/ctis-public/view/2024-517205-82-00